EU clinical trial 2024-513470-22-00: Metro-PD1-1708: a phase I/II trial evaluating anti-PD1 (Nivolumab) in combination with metronomic chemotherapy in children and teenagers with refractory /relapsing solid tumors
Protocol code: Metro-PD1-1708
Sponsor: Centre Oscar Lambret (Pharmaceutical company). Phase: Phase I and Phase II (Integrated)- Other. Countries: France (ended).
Therapeutic area(s): Diseases [C] - Neoplasms [C04]
Gender: Female, Male. Age: 0-17 years, 18-64 years. Enrolment: 63.
Status: Ended. Start date (EU): 2019-03-22. End date (EU): 2025-12-27. Decision date: 2024-10-11. Results received: Yes. Last updated: 2026-05-26.

Condition(s): Progressive or refractory paediatric solid tumor
Product: CAPECITABINE, NIVOLUMAB, CYCLOPHOSPHAMIDE, VINBLASTINE

Primary endpoint: First stage : The Dose-Limiting Toxicity (DLT) will be assessed over the first two 28-day cycles, according to the NCI CTCAE V5, Second stage : Progression-free survival (PFS) computed as the time interval from the date of randomization to the date of centrally-assessed progression or death from any cause
Endpoint(s): • Adverse events (type, grade) graded according to the NCI CTCAE V5. All AE occurring during treatment or in the 28 days after end of treatment will be reported, regardless of reported causal relationship, except symptoms unequivocally related to the underlying disease or disease progression.DLT and SAEs will be reported directly to the sponsor over the whole treatment duration plus 28 days, for all patients, in both arms. Liver-related laboratory abnormalities (DILI) will be reported., • Tumor response during treatment, centrally assessed, using RANO (for stage 1) or RAPNO (for LGG)/ WHO / INRC / RECIST 1.1 as appropriate (cf. hereinabove). The best overall response will be defined as the best response recorded from randomization over the whole study treatment duration., • Overall survival, computed as the time interval from the date of randomization to the date of death from any cause. Survival of patients alive at last follow-up will be censored at the date of last visit (3 years after last inclusion)., • Relative dose-intensity of the different drugs, estimated for each drug as the ratio between the computed dose-intensity (cumulative dose expressed in mg/m² divided by the study duration and expressed in mg/m²/week) and the protocol dose-intensity; RDI will be assessed at both stages of the study., • Relevant molecular alterations like specific gene mutations or fusions will be described for each patient treated during phase 2., • Ancillary : Trans-MetroPD1 study : Health Related Quality of Life (HRQoL) HRQoL of Life is evaluated using the age-appropriate KINDL-R questionnaire (self- and proxy-assessment in paper format) before the start of treatment (ideally within 2 weeks), at each tumor assessment during the whole course of treatment, then at disease progression or just before the start of a new treatment if end of MetroPD1 treatment is not motivated by progressive disease., • Ancillary: Progastrin (hPG80) dosage is performed on plasma samples collected the same day as the following exams: baseline imaging, tumor assessment during the whole course of treatment (until progression or end of treatment). The measurement at different times: - predictive value for progression of single hPG80 measurement before treatment, - of single hPG80 measurement at tumor assessment - of hPG80 variations measurement and hPG80 variations

Source: https://euclinicaltrials.eu/ctis-public/view/2024-513470-22-00